EU clinical trial 2024-513561-39-00: Single Dose Pharmacokinetics and Relative Bioavailability of Sayana Press via Upper Arm Injection Relative to Anterior Thigh and Abdomen
Protocol code: A6791042
Sponsor: Pfizer Inc. (Pharmaceutical company). Phase: Human Pharmacology (Phase I)- Other. Countries: Belgium (ended).
Therapeutic area(s): Not possible to specify
Gender: Female. Age: 18-64 years, 65+ years. Enrolment: 67.
Status: Ended. Start date (EU): 2021-09-08. End date (EU): 2025-07-24. End date: 2025-07-25. Decision date: 2024-06-27. Results received: No. Last updated: 2025-06-02.

Condition(s): long-term female contraception

Source: https://euclinicaltrials.eu/ctis-public/view/2024-513561-39-00